EU clinical trial 2024-511477-29-00: AFAN trial. Phase Ib/II study to investigate the safety and efficacy of Afatinib when administered as therapy in Fanconi anemia patients with unresectable and / or metastatic locoregionally advanced squamous cell carcinoma of the oral cavity, oropharynx or hypopharynx or larynx
Protocol code: IRSSP-001
Sponsor: Fundacio Institut De Recerca De L Hospital De La Santa Creu I Sant Pau (Hospital/Clinic/Other health care facility). Phase: Therapeutic exploratory (Phase II). Countries: Spain (ongoing, recruiting), Germany (authorised, recruiting).
Therapeutic area(s): Diseases [C] - Neoplasms [C04]; Not possible to specify
Gender: Female, Male. Age: 18-64 years, 65+ years. Enrolment: 25.
Start date (EU): 2024-11-08. Decision date: 2024-08-01. Results received: No. Last updated: 2025-06-03.
Decision dates by country: DE: 2025-06-03, ES: 2024-08-01

Condition(s): Patients diagnosed with unresectable and / or metastatic locoregionally advanced squamous cell carcinoma of the oral cavity, oropharynx or hypopharynx or larynx secondary to Fanconi anemia.
Product: GIOTRIF 40 mg film-coated tablets, GIOTRIF 30 mg film-coated tablets, GIOTRIF 20 mg film-coated tablets

Primary endpoint: Efficacy: To evaluate antitumor activity by means of: ORR according to RECIST V1.1
Endpoint(s): Duration of response (DoR)., Disease control rate (DCR)., Disease-free survival (DFS) according to RECIST V1.1., Overall survival (OS)., Health-related quality of life (HRQoL), Pharmacodinamics, Safety: To evaluate safety and tolerability of afatinib in participants with FA and HNSCC. Safety will be assessed by the frequency and severity of adverse events and Treatment-related adverse events (TRAEs) assessed by NCI CTCAE v5.0

Source: https://euclinicaltrials.eu/ctis-public/view/2024-511477-29-00